EU clinical trial 2024-510582-42-02: Phase 2 Open Label Prospective Dose-Ranging Clinical Trial with Escalation and Expansion Cohorts to Evaluate Safety, Tolerability, Pharmacokinetics, Pharmacodynamics, Dosing, and Efficacy of RLS-0071 for the Treatment of Hospitalized Patients with Steroid -Refractory Acute Graft-versus-Host Disease
Protocol code: RLS-0071-203
Sponsor: Realta Life Sciences Inc. (Pharmaceutical company). Phase: Therapeutic exploratory (Phase II). Countries: Germany (ended), Spain (ended).
Therapeutic area(s): Phenomena and Processes [G] - Immune system processes [G12]
Gender: Female, Male. Age: 0-17 years, 18-64 years, 65+ years. Enrolment: 16.
Status: Ended. Start date (EU): 2025-08-14. End date (EU): 2026-02-17. End date: 2026-02-18. Decision date: 2024-11-11. Results received: No. Last updated: 2026-01-28.
Decision dates by country: ES: 2024-11-11, DE: 2024-11-20

Condition(s): Acute graft versus host disease (aGvHD)
Product: IALILEPICCQERAA peptide sequence with a monodisperse polyethylene glycol tail

Primary endpoint: Safety and tolerability of RLS-0071 in the treatment of aGvHD., ORR of RLS-0071 at 28 days (note that addition of any acute GvHD therapy, including an increase in steroid dose >2 mg/kg MPE, will be considered a treatment failure).
Endpoint(s): CR at 7, 14, 28, 56, and 180 days., VGPR Rate at 7, 14, 28, 56, and 180 days., PR Rate at 7, 14, 28, 56, and 180 days., ORR at 7, 14, 56, and 180 days., ORR focused on lower GI response criteria only at 7, 14, 28, 56, and 180 days (for the overall study population and for the subset with lower GI aGvHD)., CR, VGPR, and PR Rates focused on lower GI response criteria only at 7, 14, 28, 56, and 180 days (for the overall study population and for the subset with lower GI aGvHD)., Incidence of refractoriness (to RLS-0071 +/- ruxolitinib) at Days 7, 14, 28, 56, and 180; refractoriness is defined as at least one of the following: aGvHD increasing in Stage in any organ or developing in a new organ after 3 days of RLS-0071; aGvHD that has not improved in Stage in >1 organ after 7 days of RLS-0071; initiation of additional aGvHD treatment (other than RLS-0071 +/- ruxolitinib); or for after Day 7, participants who progress during corticosteroid tapering before a 50% decrease in, Overall corticosteroid use on Days 7, 14, 28, 56, and 180., Initiation of additional or alternative treatment(s) for aGvHD (including an increase in steroid dose to >2 mg/kg methylprednisolone equivalent) to treat refractory aGvHD., Change or shift in Stage for lower GI aGvHD, liver aGvHD, skin aGvHD, or upper GI aGvHD from baseline to Days 7, 14, 28, 56, and 180., Attainment of Stage 0 or 1 lower GI aGvHD, liver aGvHD, skin aGvHD, or upper GI aGvHD at Days 7, 14, 28, 56, and 180., Change or shift in overall Grade of aGvHD (Table 8) from baseline to Days 7, 14, 28, 56, and 180., Loss of response, reduction in response, or incidence of flare in participants who had an initial response to RLS-0071 (with systemic corticosteroids and +/- ruxolitinib)., Dose response (dose and duration) for the primary and secondary efficacy endpoints (across the dose regimens in the study)., Overall survival, failure-free survival, and non-relapse mortality., Pharmacokinetics (based on sparse sampling for all participants and intensive sampling for a subset of participants) of RLS-0071., aGvHD patient outcomes: FACT-BMT, abdominal pain, volume/frequency of diarrhea, food tolerance and use of TPN, and duration of hospital stay., Change in MAGIC biomarkers (ST2 and REG3a) at Days 7, 14, and 28.

Source: https://euclinicaltrials.eu/ctis-public/view/2024-510582-42-02